EU clinical trial 2023-504087-42-00: A Phase 3, Randomized, Double-blind, Placebo-controlled Study to Evaluate the Efficacy and Safety of Plitidepsin in Adults with Post COVID-19 Condition
Protocol code: THALASA
Sponsor: Fundacion Fls De Lucha Contra El Sida Las Enfermedades Infecciosas Y La Promocion De La Salud Y La Ciencia (Patient organisation/association). Phase: Therapeutic confirmatory (Phase III). Countries: Spain (not authorised).
Therapeutic area(s): Diseases [C] - Virus Diseases [C02]
Gender: Female, Male. Age: 18-64 years. Enrolment: 260.
Status: Not authorised. Decision date: 2023-08-10. Results received: No. Last updated: 2023-08-10.

Condition(s): Post COVID-19
Product: FAMOTIDINE, APLIDIN, DEXAMETHASONE PHOSPHATE, PLACEBO, DEXCHLORPHENIRAMINE, PALONOSETRON

Primary endpoint: Percentage of patients with PPC who improve at least one grade on the functional status measured with Post COVID-19 Functional Status Scale (PCFS https://medicaljournalssweden.se/jrm-cc/article/view/2652) at 28+/-2 days post-drug infusion.
Endpoint(s): Percentage of patients with PCC who improve at least one grade on the PCFS at 10+/-2 days post-drug infusion, Percentage of patients with PCC with Grade 0 or 1 functional disability, according to PCFS, at 10+/-2, 28+/-2 and 90+/-5 days post-drug infusion, Proportion of adverse events (AEs) (coded by MedDRA) through at 1-3, 10+/-2, 28+/-2 and 90+/-5 days post-drug infusion considering: 1) All AEs; 2) AEs leading to study discontinuation; 3) AEs of special interest (AESI): cardiac, liver, acute post-infusional reactions., Proportion of subjects with ≥10 points reduction in Can Ruti´s Questionnaire scale at 10+/-2, 28+/-2 and 90+/-5 days post-drug infusion, Proportion of subjects with improvement in Quality of Life (QoL) according to European Quality of life-5D (EuroQol-5D) questionnaire at10+/-2, 28 +/-2, and 90+/-5 days post-drug infusion., Change respect to baseline in neurocognitive symptoms by 28 +/-2, and 90+/-5 days post-drug infusion assessed with the following questionnaires: Neu Screen (velocidad psicomotora y función ejecutora); MEF-30 (discapacidad cognitiva percibida); HADS (síntomas depresivos y ansiosos); PSQI (valoración del insomnio) y WHODAS 2.0., Change respect to baseline in physical activity by 10+/-2, 28 +/-2, and 90+/-5 days post-drug infusion assessed with the International Activity Questionary (IPAQ)., Change respect to baseline in physical activity by 10+/-2, 28 +/-2, and 90+/-5 days post-drug infusion assessed with the Fatigue severe scale (FSS) and Five Times Sit to Stand Test (5xSTS)., Change respect to baseline in inflammatory, microbiological and immunological biomarkers by Days 10 +/-2, 28 +/-2, and 90+/-5 days post-drug infusion., Change respect to baseline in immune cells by 10 +/-2, 28 +/-2, and 90+/-5 days post-drug infusion, Change respect to baseline in individual serological assessments at 90+/-5 days post-drug infusion., Change respect to baseline in viral components in plasma by 10 +/-2, 28 +/-2, and 90+/-5 days post-drug infusion., Change respect to baseline in immune response markers by 10 +/-2, 28 +/-2, and 90+/-5 days post-drug infusion., Change respect to visit 2 (first infusion) in faecal microbiota by 10 +/-2, 28 +/-2, and 90+/-5 days post-drug infusion.

Source: https://euclinicaltrials.eu/ctis-public/view/2023-504087-42-00